EU clinical trial 2024-516733-12-00: A study of the PAN-KRAS inhibitor LY4066434 in participants with KRAS mutant solid tumors.
Protocol code: J5Q-OX-JRDA
Sponsor: Eli Lilly & Co. (Pharmaceutical company). Phase: Human Pharmacology (Phase I)- First administration to humans. Countries: Belgium (ongoing, recruitment ended), Spain (ongoing, recruitment ended), Germany (ongoing, recruitment ended), France (ended), Italy (ongoing, recruitment ended).
Therapeutic area(s): Diseases [C] - Neoplasms [C04]
Gender: Female, Male. Age: 18-64 years, 65+ years. Enrolment: 353.
Start date (EU): 2025-05-13. Decision date: 2024-11-20. Results received: No. Last updated: 2026-08-03.
Decision dates by country: FR: 2025-06-27, ES: 2025-05-08, BE: 2024-11-20, IT: 2025-07-28, DE: 2025-06-04

Condition(s): Pancreatic Ductal Adenocarcinoma, Non-small Cell Lung Cancer, Colorectal Cancer, Advanced Solid Tumor Metastatic Solid Tumor, PanKRAS.

Source: https://euclinicaltrials.eu/ctis-public/view/2024-516733-12-00